EU clinical trial 2024-513350-30-00: DiaPrecise, A Phase II Open Label Study to evaluate the safety and feasibility of intralymphatic administration of Diamyd® in individuals at risk for Type 1 diabetes carrying the HLA DR3-DQ2 haplotype
Protocol code: D/P2/22/8
Sponsor: Diamyd Medical AB (Pharmaceutical company). Phase: Therapeutic exploratory (Phase II). Countries: Sweden (ended).
Therapeutic area(s): Phenomena and Processes [G] - Metabolism [G03]
Gender: Female, Male. Age: 0-17 years. Enrolment: 16.
Status: Ended. Start date (EU): 2024-07-09. End date (EU): 2026-04-29. Decision date: 2024-06-19. Results received: No. Last updated: 2026-04-10.

Condition(s): Type 1 diabetes mellitus
Product: Diamyd

Primary endpoint: The primary endpoint in this study is to evaluate the feasibility and safety of two or three injections of Diamyd, administered into an inguinal lymph node.

Source: https://euclinicaltrials.eu/ctis-public/view/2024-513350-30-00